EU clinical trial 2023-504715-33-00: A Phase 3B, Multicenter, Randomized, Double-blind, Placebo-controlled Study Evaluating the Efficacy and Safety of Guselkumab Administered Subcutaneously in Participants with Active Psoriatic Arthritis who had an Inadequate Response and/or Intolerance to One Prior Anti-Tumor Necrosis Factor α Agent
Protocol code: CNTO1959PSA3005
Sponsor: Janssen - Cilag International (Pharmaceutical company). Phase: Therapeutic confirmatory (Phase III). Countries: Hungary (ended), Spain (ended), Czechia (ended), Poland (ended), Bulgaria (ended).
Therapeutic area(s): Diseases [C] - Immune System Diseases [C20]
Gender: Female, Male. Age: 18-64 years, 65+ years. Enrolment: 229.
Status: Ended. Start date (EU): 2021-09-27. End date (EU): 2026-07-02. End date: 2026-07-03. Decision date: 2024-04-19. Results received: No. Last updated: 2026-01-20.
Decision dates by country: PL: 2024-04-22, BG: 2024-05-29, CZ: 2024-04-23, HU: 2024-04-19, ES: 2024-04-22

Condition(s): Psoriatic Arthritis
Product: Guselkumab 1 mL PFS Placebo, Guselkumab - solution for injection in pre-filled syringe - 100 mg/mL

Primary endpoint: Proportion of participants who achieve an ACR 20 response at Week 24

Source: https://euclinicaltrials.eu/ctis-public/view/2023-504715-33-00